EU clinical trial 2024-514754-79-00: A Phase 2, Randomized, Double-Blind, Placebo-Controlled Study to Assess the Efficacy, Safety, Pharmacokinetics, and Pharmacodynamic Effects of REGN13335, an Anti-PDGF-B Monoclonal Antibody, in Adults with Pulmonary Arterial Hypertension
Protocol code: R13335-PAH-2365
Sponsor: Regeneron Pharmaceuticals Inc. (Pharmaceutical company). Phase: Therapeutic exploratory (Phase II). Countries: Latvia (ongoing, recruiting), Belgium (authorised, recruitment pending), France (authorised, recruitment pending), Poland (authorised, recruitment pending), Germany (authorised, recruitment pending), Spain (authorised, recruitment pending), Czechia (authorised, recruitment pending).
Therapeutic area(s): Diseases [C] - Cardiovascular Diseases [C14]
Gender: Female, Male. Age: 18-64 years, 65+ years. Enrolment: 47.
Start date (EU): 2026-05-06. Decision date: 2026-03-18. Results received: No. Last updated: 2026-07-29.
Decision dates by country: BE: 2026-03-18, DE: 2026-03-26, LV: 2026-03-18, ES: 2026-03-26, PL: 2026-03-27, CZ: 2026-04-20, FR: 2026-03-20

Condition(s): Pulmonary Arterial Hypertension (PAH)
Product: REGN13335, REGN13335, Placebo to REGN13335

Primary endpoint: Change from baseline in Pulmonary Vascular Resistance (PVR)
Endpoint(s): Occurrence of Treatment-Emergent Adverse Events (TEAEs), Severity of TEAEs, Change from baseline in circulating N-Terminal pro-B-type Natriuretic Peptide (NT-proBNP) concentrations, Change from baseline in mean pulmonary artery pressure, Change from baseline in cardiac output, Change from baseline in cardiac index, Change from baseline in right atrial pressure, Change from baseline in 6-Minute Walk Distance (6MWD), Concentrations of functional REGN13335 in plasma, Concentrations of total soluble Platelet-Derived Growth Factor-B (PDGF-B) ligands in plasma

Source: https://euclinicaltrials.eu/ctis-public/view/2024-514754-79-00